EU clinical trial 2024-519533-38-00: A study to see the effect of NNC0194-0499 alone or in combination with semaglutide on blood sugar control in people living with type 1 diabetes.
Protocol code: NN6497-8316
Sponsor: Novo Nordisk A/S (Pharmaceutical company). Phase: Human Pharmacology (Phase I)- Other. Countries: Germany (ongoing, recruitment ended).
Therapeutic area(s): Diseases [C] - Nutritional and Metabolic Diseases [C18]
Gender: Female, Male. Age: 18-64 years. Enrolment: 96.
Status: Ongoing, recruitment ended. Start date (EU): 2025-06-24. Decision date: 2025-05-28. Results received: No. Last updated: 2026-07-27.

Condition(s): Diabetes mellitus type 1

Source: https://euclinicaltrials.eu/ctis-public/view/2024-519533-38-00